EU clinical trial 2025-521988-13-00: ANTIMIDIS - Cefazolin mediastinal distribution using microdialysis
Protocol code: APHP241591
Sponsor: Assistance Publique Hopitaux De Paris (Hospital/Clinic/Other health care facility). Phase: Therapeutic use (Phase IV). Countries: France (authorised, recruitment pending).
Therapeutic area(s): Diseases [C] - Bacterial Infections and Mycoses [C01]
Gender: Female, Male. Age: 0-17 years. Enrolment: 10.
Status: Authorised, recruitment pending. Decision date: 2026-06-05. Results received: No. Last updated: 2026-07-09.

Condition(s): Infection prophylaxis
Product: CEFAZOLIN

Primary endpoint: Population pharmacokinetic parameters and inter-individual variability: distribution volume, total clearance, intercompartmental clearance (plasma to mediastinum)
Endpoint(s): Monte Carlo simulations performed using the model with SimulX (version 2024R1) and R (version 4.4.2) software, Data collected during the month following probe removal: Clinical progression: survival or death, post-operative mediastinitis, other bacterial infections, MIC of the bacteria if measured; Antibiotics received; Inflammation markers and progression: CRP.

Source: https://euclinicaltrials.eu/ctis-public/view/2025-521988-13-00